EU clinical trial 2023-503794-38-00: (19767 OCEANIC-AF) A multicenter, international, randomized, active comparator-controlled, double-blind, double-dummy, parallel-group, 2-arm, Phase 3 study to compare the efficacy and safety of the oral FXIa inhibitor asundexian (BAY 2433334) with apixaban for the prevention of stroke or systemic embolism in male and female participants aged 18 years and older with atrial fibrillation at risk for stroke
Protocol code: 19767
Sponsor: Bayer AG (Pharmaceutical company). Phase: Therapeutic confirmatory (Phase III). Countries: Finland (ended), Norway (ended), Denmark (ended), Hungary (ended), Spain (ended), Estonia (ended), Sweden (ended), Czechia (ended), Austria (ended), Lithuania (ended), Belgium (ended), Romania (ended), Slovakia (ended), Portugal (ended), Italy (ended), Latvia (ended), Netherlands (ended), Poland (ended), Greece (ended), Germany (ended), Bulgaria (ended), France (ended).
Therapeutic area(s): Diseases [C] - Cardiovascular Diseases [C14]
Gender: Female, Male. Age: 18-64 years, 65+ years. Enrolment: 9578.
Status: Ended. Start date (EU): 2022-11-24. End date (EU): 2024-01-23. End date: 2024-01-31. Decision date: 2023-09-08. Results received: Yes. Last updated: 2023-10-26.
Decision dates by country: AT: 2023-09-13, BE: 2023-09-18, BG: 2023-10-23, CZ: 2023-09-08, DK: 2023-09-08, EE: 2023-09-12, FI: 2023-09-11, FR: 2023-10-26, DE: 2023-10-16, GR: 2023-10-19, HU: 2023-09-12, IT: 2023-10-03, LV: 2023-09-15, LT: 2023-09-14, PT: 2023-09-15, RO: 2023-09-22, ES: 2023-09-12, SE: 2023-09-08, NL: 2023-09-14, NO: 2023-09-13, PL: 2023-10-18, SK: 2023-09-27

Condition(s): Prevention of stroke or systemic embolism in atrial fibrillation
Product: Placebo for comparator product Apixaban 5mg, Placebo for test product BAY 2433334, Eliquis 5 mg film-coated tablets, Eliquis 2.5 mg film-coated tablets, BAY 2433334, Placebo for comparator product Apixaban 2.5mg

Primary endpoint: Time to first occurrence of composite of stroke or systemic embolism, Time to first occurrence of ISTH major bleeding, Time to first occurrence of composite of stroke, systemic embolism, or ISTH major bleeding
Endpoint(s): Time to first occurrence of composite of ischemic stroke or systemic embolism, Time to first occurrence of all-cause mortality, Time to first occurrence of ischemic stroke, Time to first occurrence of cardiovascular (CV) death, Time to first occurrence of composite of CV death, stroke, or myocardial infarction, Time to first occurrence of composite of ISTH major or clinically relevant non-major bleeding, Time to first occurrence of clinically relevant non-major bleeding, Time to first occurrence of hemorrhagic stroke, Time to first occurrence of intracranial hemorrhage, Time to first occurrence of fatal bleeding, Time to first occurrence of minor bleeding, Time to first occurrence of composite of stroke, systemic embolism, ISTH major bleeding, or all-cause mortality, Time to first occurrence of composite of disabling stroke (modified Rankin Scale (mRS) >=3), critical bleeding, or all-cause mortality

Source: https://euclinicaltrials.eu/ctis-public/view/2023-503794-38-00